EU clinical trial 2023-508382-33-01: A study to Assess the Effect of Fluvoxamine (CYP2C19 Inhibitor), Itraconazole (CYP3A4 Inhibitor) and Paroxetine (CYP2D6 Inhibitor) on the Pharmacokinetics of ASN51 in Healthy Subjects.
Protocol code: ASN51-104
Sponsor: Asceneuron S.A. (Pharmaceutical company). Phase: Human Pharmacology (Phase I)- Other. Countries: Netherlands (ended).
Therapeutic area(s): Diseases [C] - Nervous System Diseases [C10]
Gender: Female, Male. Age: 18-64 years. Enrolment: 48.
Status: Ended. Start date (EU): 2024-02-22. End date (EU): 2024-07-03. Decision date: 2024-02-20. Results received: No. Last updated: 2024-02-20.

Condition(s): Proteinopathies

Source: https://euclinicaltrials.eu/ctis-public/view/2023-508382-33-01